EU clinical trial 2024-514001-65-00: Phase I clinical trial of TG4050 combined with nivolumab in patients with Non-Small Cell Lung Cancer.
Protocol code: TG4050.03
Sponsor: Transgene (Pharmaceutical company). Phase: Human Pharmacology (Phase I)- Other. Countries: France (authorised, recruitment pending).
Therapeutic area(s): Diseases [C] - Neoplasms [C04]
Gender: Female, Male. Age: 18-64 years, 65+ years. Enrolment: 20.
Status: Authorised, recruitment pending. Decision date: 2024-10-03. Results received: No. Last updated: 2025-03-28.

Condition(s): Non-Small Cell Lung Cancer

Source: https://euclinicaltrials.eu/ctis-public/view/2024-514001-65-00